EU clinical trial 2024-517922-24-00: A phase I/II post-cord blood HCT dendritic cell vaccination trial directed against WT1 for pediatric and young adult acute myeloid leukemia: the U-DANCE-anti-AML trial.
Protocol code: SP_PT18UDA
Sponsor: Prinses Maxima Centrum voor Kinderoncologie B.V. (Hospital/Clinic/Other health care facility). Phase: Human Pharmacology (Phase I)- First administration to humans. Countries: Netherlands (temporarily halted).
Therapeutic area(s): Diseases [C] - Hemic and Lymphatic Diseases [C15]
Gender: Female, Male. Age: 0-17 years, 18-64 years. Enrolment: 54.
Status: Temporarily halted. Start date (EU): 2023-12-06. Decision date: 2024-11-27. Results received: No. Last updated: 2025-07-11.

Condition(s): AML: Acute Myeloid Leukemia/ cancer of blood and bone marrow
Product: WT1-loaded CBDC Vaccine

Primary endpoint: Part A: Safety: Occurrence of DLTs from the first vaccination (t=0) until 84 days after the third CBDC vaccination. The 6 patients receiving dose that is considered safe will also be included in first stage of the 2-stage phase 2 design., Part B: Activity: One-year WT1+ AML relapse-free survival rate from the time of the first vaccination as compared to historic controls.
Endpoint(s): Part A + B: One-year cumulative incidence of cGvHD (according to NIH criteria91) from the first vaccination until one year of follow-up., Part A + B: One-year overall survival rate from the time of first vaccination., Part A + B: One-year WT1+AML relapse-free survival rate, from the time of first vaccination., 4. Part A+B: One-year cumulative increase of WT1-specific immunity defined by In vitro T cell reactivity towards MHC class I and II-restricted WT1 epitopes by multiplex-cytokine assay and FACS of CD8/CD137 and CD4/CD154 expression by PBMCs stimulation with WT1 peptivator. Quantitative and qualitative FACS analysis of WT1-specific-positive CD8+ T cells using HLA-A2 multimers against a wide range of possible WT1 peptides.

Source: https://euclinicaltrials.eu/ctis-public/view/2024-517922-24-00